EU clinical trial 2023-508614-41-00: A multi-center randomized phase II study comparing corticosteroids alone versus corticosteroids and extracorporeal photopheresis as first-line treatment of Grade II acute graft-versus-host disease with skin involvement occuring after allogeneic stem cell transplantation - COPAVEHDI
Protocol code: 2023-0038
Sponsor: CHRU De Nancy (Hospital/Clinic/Other health care facility). Phase: Therapeutic exploratory (Phase II). Countries: France (ongoing, recruiting).
Therapeutic area(s): Diseases [C] - Immune System Diseases [C20]
Gender: Female, Male. Age: 18-64 years. Enrolment: 124.
Status: Ongoing, recruiting. Start date (EU): 2024-10-15. Decision date: 2024-03-20. Results received: No. Last updated: 2026-07-21.

Condition(s): The study will be proposed to all adult patients receiving an allogeneic hematopopietic stem cell transplantation and presenting a Grade II acute GVH with skin +/- upper gastrointestinal involvement, in transplant centers contributing to this trial (departments of hematology).
Product: Uvadex 20 microgrammes/ ml. Solution pour la modification de fractions sanguines, CORTANCYL 20 mg, comprimé sécable, SOLUMEDROL 500 mg, poudre pour solution injectable, Noxafil 40 mg/mL oral suspension

Primary endpoint: Percentage of patients without treatment failure at 6 months in each arm. Absence of treatment failure is defined by meeting all the following 4 conditions at 6 months from randomization:1/to be alive, 2/without relapse of the hematological disease, 3/without having required a new line of treatment for acute GVHD,4/without initiating a systemic treatment for chronic GVHD
Endpoint(s): The mean of the cumulative dose of steroids over time (randomization-1 month, 1-2 month, 2-3 month, 3-6 month and 6-12 month periods),, The cumulative incidence rate of infections at 6 and 12 months (bacteremia, septicemia, fungal infection and virus reactivation),, The cumulative incidence of thromboembolic complications at 3 months (diagnosed with Doppler ultrasound exam and/or CT coronary angiogram performed in case of indicative clinical symptoms), the incidence and severity of chronic GVHD (according to NIH criteria19) at 6 and 12 months after randomization (see Annex 4),, the non-relapse mortality rate at 6 and 12 months (death due to any cause except underlying disease relapse), the incidence of underlying disease relapse at 6 and 12 months after randomization (relapse is defined on the basis of morphological evidence of leukemic or lymphoma cells in the bone marrow or other sites),, the disease-free survival at 6 and 12 months after randomization (time from randomization date to either first relapse or death from any cause),, the overall survival at 6 and 12 months after randomization (time from randomization date to either first relapse or death from any cause), the mean scores of health-related quality of life using the French validated FACT-BMT (version 4.0, see Annex 5) at 3, 6 and 12 months after transplant,, immune reconstitution based on peripheral blood testing (rate of total T lymphocytes, CD4 and CD8 T cells, B cells, NK cells, gamma globulins) at 3, 6 and 12 months after randomization (depending on usual practices in each center).

Source: https://euclinicaltrials.eu/ctis-public/view/2023-508614-41-00